EU clinical trial 2025-521153-16-00: A double-blind, multi-centre, randomized, placebo-controlled cross-over clinical trial to assess the efficacy of doxyPEP in reducing the incidence of bacterial STIs among MSM and TGW living with HIV in Belgium (DoxHIV study)
Sponsor: Institute Of Tropical Medicine (Hospital/Clinic/Other health care facility). Phase: Therapeutic confirmatory (Phase III). Countries: Belgium (ongoing, recruiting).
Therapeutic area(s): Diseases [C] - Bacterial Infections and Mycoses [C01]
Gender: Male. Age: 18-64 years, 65+ years. Enrolment: 200.
Status: Ongoing, recruiting. Start date (EU): 2025-12-05. Decision date: 2025-06-02. Results received: No. Last updated: 2025-06-02.

Condition(s): bacterial sexually transmitted infections
Product: Placebo capsules for Doxycycline 200 mg (Empty Hpmc capsule, vcaps plus, swedish orange filled with microcrystalline cellulose), Doxycycline EG 100 mg tabletten

Primary endpoint: Incidence rate ratio of symptomatic NG, CT, and all TP infections in the doxyPEP vs placebo arms
Endpoint(s): Rate ratio of tetracyclines, macrolides, cephalosporins, and penicillins in the doxyPEP vs placebo arms, MIC distribution (doxycycline/cefixime/ciprofloxacin) of commensal Neisseria spp. and E. coli in the doxyPEP vs placebo arms, Microbiota diversity, microbiota richness, abundance and diversity of Bifidobacteria, Fusobacterium, Lactobacillaceae, Enterobacteriaceae and Bacteroidaceae in both arms. Abundance of resistance genes (tetracyclines and other classes of antimicrobials) in both arms, Incidence rate ratio of symptomatic NG infections in the doxyPEP vs placebo arms, Incidence rate ratio of symptomatic CT infections in the doxyPEP vs placebo arms, Incidence rate ratio of symptomatic TP infections in the doxyPEP vs placebo arms, Incidence rate ratio of all NG infections in the doxyPEP vs placebo arms, Incidence rate ratio of all CT infections in the doxyPEP vs placebo arms, Incidence rate ratio of all TP infections in the doxyPEP vs placebo arms, Tetracycline MIC distribution of NG isolates in the doxyPEP vs placebo arms

Source: https://euclinicaltrials.eu/ctis-public/view/2025-521153-16-00